EU clinical trial 2023-506288-33-00: MK-5684-01A Substudy: A Phase 1/2 Umbrella Substudy of MK-5684-U01 Master Protocol to Evaluate the Safety and Efficacy of MK-5684-based Treatment Combinations or MK-5684 Alone in Participants With Metastatic Castration-resistant Prostate Cancer (mCRPC) (OMAHA-01A)
Protocol code: MK-5684-01A
Sponsor: Merck Sharp & Dohme LLC (Pharmaceutical company). Phase: Phase I and Phase II (Integrated)- Other. Countries: Spain (ongoing, recruiting), Italy (ongoing, recruiting), Ireland (ongoing, recruiting), Denmark (ongoing, recruiting), Germany (ongoing, recruiting), Poland (ongoing, recruiting), France (ongoing, recruiting), Finland (ongoing, recruiting).
Therapeutic area(s): Diseases [C] - Neoplasms [C04]
Gender: Male. Age: 18-64 years, 65+ years. Enrolment: 127.
Status: Ongoing, recruiting. Start date (EU): 2025-03-03. Decision date: 2024-07-23. Results received: No. Last updated: 2026-05-22.
Decision dates by country: PL: 2024-08-07, IT: 2024-07-31, DE: 2024-09-04, IE: 2024-08-02, FI: 2024-09-04, DK: 2024-07-29, ES: 2024-07-23, FR: 2024-07-29

Condition(s): Metastatic castration resistant prostate cancer (mCRPC)
Product: Opevesostat, CABAZITAXEL, FLUDROCORTISONE, Olaparib, HYDROCORTISONE, DEXAMETHASONE, Olaparib, DOCETAXEL

Primary endpoint: Number of participants who experience one or more dose-limiting toxicities (DLTs), Number of participants who experience one or more adverse events (AEs), Number of participants who discontinue study intervention due to an AE, Prostate-specific antigen (PSA) response rate
Endpoint(s): Objective response rate (ORR), Radiographic progression-free survival (rPFS), Overall survival (OS), Duration of response (DOR), Time to first subsequent anticancer therapy (TFST), Time to pain progression (TTPP)

Source: https://euclinicaltrials.eu/ctis-public/view/2023-506288-33-00